EU clinical trial 2025-524726-18-00: J5D-MC-FPAD: A Phase 2a, Randomized, 24-Week, Multicenter, Double-Blind, Placebo-Controlled Proof-of-Concept Study to Investigate Efficacy and Safety of LY4005130 in Adult Participants with Non-Segmental Vitiligo
Protocol code: J5D-MC-FPAD
Sponsor: Eli Lilly & Co. (Pharmaceutical company). Phase: Therapeutic exploratory (Phase II). Countries: Poland (ongoing, recruiting), Belgium (ongoing, recruiting).
Therapeutic area(s): Diseases [C] - Immune System Diseases [C20]
Gender: Female, Male. Age: 18-64 years, 65+ years. Enrolment: 14.
Status: Ongoing, recruiting. Start date (EU): 2026-07-07. Decision date: 2026-05-29. Results received: No. Last updated: 2026-06-05.
Decision dates by country: BE: 2026-05-29, PL: 2026-06-05

Condition(s): Non-Segmental Vitiligo (NSV), Vitiligo
Product: SUB12581MIG

Primary endpoint: Percentage of Participants Achieving Facial Vitiligo Area Scoring Index (F-VASI) 75

Source: https://euclinicaltrials.eu/ctis-public/view/2025-524726-18-00